EU clinical trial 2023-509780-25-00: Does the Use of Higher Versus Lower Oxygen Concentration Improve Neurodevelopmental Outcomes at 24 Months (plus or minus 6 months) in Very Low Birthweight Infants: The HiLo-Trial
Protocol code: Pro00083931
Sponsor: University College Cork (Educational Institution). Phase: Therapeutic confirmatory (Phase III). Countries: Ireland (ongoing, recruiting).
Therapeutic area(s): Diseases [C] - Congenital, Hereditary, and Neonatal Diseases and Abnormalities [C16]
Gender: Female, Male. Age: 0-17 years. Enrolment: 65.
Status: Ongoing, recruiting. Start date (EU): 2024-10-09. Decision date: 2024-05-03. Results received: No. Last updated: 2026-04-20.

Condition(s): Prematurity
Product: Medical Oxygen

Primary endpoint: The primary outcome is a composite between 18 and 24 months corrected age of all-cause mortality or the presence of a major neurodevelopmental outcome defined as any one of: (i) non-ambulatory cerebral palsy; (ii) severe cognitive delay, (iii) hearing impairment (requiring a hearing aid or cochlear implants), and (iv) visual (cannot fixate/ legally blind, or corrected acuity <6/60 in both eyes).
Endpoint(s): All-cause in-hospital mortality, Severe brain injury, defined as Grade 3 and 4 IVH / intraparenchymal hemorrhage or echodense intraparenchymal lesions, periventricular leukomalacia, porencephalic cysts or ventriculomegaly on cranial ultrasound, Bronchopulmonary dysplasia, Severe retinopathy of prematurity (stage 3 or 4 or treated cases)

Source: https://euclinicaltrials.eu/ctis-public/view/2023-509780-25-00